EU clinical trial 2024-511419-22-00: Evaluating the Diagnostic Performance of Human Epidermal Growth Factor Receptor 2 (HER2) targeted Positron Emission Tomography and Computed Tomography (PET/CT) with 68Ga-ABS011 in metastatic Breast Cancer (mBC) and other metastatic solid carcinomas.
Protocol code: ABS011-1
Sponsor: Abscint (Pharmaceutical company). Phase: Phase II and Phase III (Integrated). Countries: Belgium (ongoing, recruiting), Austria (authorised, recruitment pending).
Therapeutic area(s): Analytical, Diagnostic and Therapeutic Techniques and Equipment [E] - Diagnosis [E01]
Gender: Female, Male. Age: 18-64 years, 65+ years. Enrolment: 70.
Start date (EU): 2024-09-03. Decision date: 2024-07-17. Results received: No. Last updated: 2026-04-27.
Decision dates by country: BE: 2024-07-17, AT: 2026-04-27

Condition(s): Hormone receptor positive/HER2 negative, triple-negative or HER2 positive metastatic Breast Cancer (mBC) and other metastatic solid carcinomas

Primary endpoint: 1.Evaluation, on a per-IHC (and ISH) lesion level(I), of the diagnostic performance of 68Ga-ABS011 PET/CT(III) compared to HER2 IHC status(IV) [2] by means of: - Positive % diagnostic agreement - Negative % diagnostic agreement - Overall % diagnostic agreement
Endpoint(s): 2.Incidence rate of all adverse events (AEs) and serious AEs (SAEs) from V1 to V5 included, coded using the Medical Dictionary for Regulatory Activities (MedDRA), in terms of System Organ Class (SOC) and Preferred Term (PT)., 3.Proportion of mBC patients for whom the whole-body 68Ga-ABS011 PET/CT guided biopsy impacted the management of the mBC (driven by a revised IHC/ISH status and/or additional insights in whole-body tumor heterogeneity). If this proportion is at least 17% (1 out of 6 patients), whole body mapping via 68Ga-ABS011 PET/CT would be considered as a tool of high value, introducing clinically relevant changes in diagnostic and therapeutic management of mBC., 4.1.Positive predictive value of 68Ga-ABS011 using IHC(IV) and ISH(V) as a reference: a. Proportion of lesions with a HER2 positive 68Ga-ABS011 status and a confirmed HER2 IHC non-0 status. b. Proportion of lesions with a HER2 positive 68Ga-ABS011 status and a positive ISH status., 4.2.Negative predictive value of 68Ga-ABS011 of 68Ga-ABS011 using IHC(IV) and ISH(V) and as a reference: a. Proportion of lesions with a negative 68Ga-ABS011 status and a HER2 IHC 0 status. b. Proportion of lesions with a negative 68Ga-ABS011 status and a negative ISH status., 4.3.Positive and negative likelihood ratio of 68Ga-ABS011 PET/CT using IHC(IV) and ISH(V) as a reference., 5.1.Positive predictive value of 68Ga-ABS011 using 18F-FDG PET/ceCT(VIII) as a reference: a. The proportion of lesions with a HER2 positive 68Ga-ABS011 status and a confirmed MR after 2 cycles of HER2 targeted treatment (6 weeks post-HER2 treatment initiation). b. The proportion of lesions with a HER2 positive 68Ga-ABS011 status and an achieved ETS after 2 cycles of HER2 targeted treatment (6 weeks post-HER2 treatment initiation)., 5.2.Negative predictive value of 68Ga-ABS011 of 68Ga-ABS011 using 18F-FDG PET/ceCT(VIII) as a reference. a. Proportion of lesions with a negative 68Ga-ABS011 status confirmed by absence of MR (non-MR) after 2 cycles of HER2 targeted treatment (6 weeks post-HER2 treatment initiation). b. Proportion of lesions with a negative 68Ga-ABS011 status that did not achieve ETS after 2 cycles of HER2 targeted treatment (6 weeks post-HER2 treatment initiation)., 5.3.Positive and negative likelihood ratio of 68Ga-ABS011 PET/CT using 18F-FDG PET/ceCT(VIII) as a reference., 5.4.Assessment for all individual evaluable lesions(II), between 68Ga-ABS011 PET/CT HER2 status and treatment response assessed on 18F-FDG PET/ceCT(VIII) completed at screening and after 2 cycles of HER2 targeted treatment by means of: Assessment for all individual evaluable lesions(II), of the positive, negative and overall agreement between 68Ga-ABS011 PET/CT HER2 status and treatment response; i.e., Metabolic Response (MR) and Early Tumor Shrinkage (ETS) assessed on 18F-FDG PET/ceCT., 6.Inter-tumor heterogeneity assessment by measuring the proportion of discordance between the total number of lesions and number of overlapping lesions confirmed on 18F-FDG and/or 68Ga-ABS011 PET/CT(VIII) and contrast enhanced CT., 7.Correlating on a per patient level the proportion of 68Ga-ABS011 PET/CT HER2 positive and negative lesions with the available early treatment outcomes (i.e. MR and ETS).

Source: https://euclinicaltrials.eu/ctis-public/view/2024-511419-22-00